EU clinical trial 2024-512561-13-00: Oral Prednisolone for Acute Rhinovirus Induced Wheezing in Children Less Than 2 Years of Age: RhinoPOC RCT
Sponsor: University Of Oulu (Educational Institution). Phase: Therapeutic use (Phase IV). Countries: Finland (ongoing, recruiting).
Therapeutic area(s): Diseases [C] - Respiratory Tract Diseases [C08]
Gender: Female, Male. Age: 0-17 years. Enrolment: 210.
Status: Ongoing, recruiting. Start date (EU): 2022-02-11. Decision date: 2024-04-10. Results received: No. Last updated: 2024-04-10.

Condition(s): Rhinovirus-induced Wheezing
Product: SUCROSE, PREDNISOLONE SODIUM PHOSPHATE

Primary endpoint: The difference (in minutes) between the study entry and the time that the patient is deemed to be fit for discharge (sign off for discharge)
Endpoint(s): The total length of hospital stay (the difference between the study entry and the actual time of discharge from the hospital) (in minutes), Intensive care unit (ICU) admission, The total duration of the need for supplemental oxygen (in minutes), The maximum decrease in PEWS score within 12 hours after study entry. PEWS scores range from 0 to 32, depending on the child's respiratory rate, work of breathing, saturation of peripheral oxygen, need for supplemental oxygen, blood pressure, heart rate, capillary refill and level of consciousness. 0 refers to low and > 7 to high risk of deterioration., The recurrence of wheezing after the initial episode within the 56 days following study enrollment, Hospital readmission or emergency department visit occurring within 56 days after discharge from the hospital following study enrollment, Cough at 14 days of study entry, The duration of cough (without relapse within 3 days) during the 14 days following study enrollment (in days), The duration of cough (without relapse within 3 days) during the 28 days following study enrollment (in days), The total number of days of salbutamol use during the 14 days following study enrollment, The duration of respiratory distress (without relapse within 3 days) during the 14 days following study enrollment (in days), Death of any cause, The recurrence of wheezing diagnosed by a physician after the initial episode within two months following study enrollment, The recurrence of wheezing diagnosed by a physician after the initial episode within 12 months following study enrollment, Time to recurrence of wheezing diagnosed by a physician withing one year following study enrollment (in days), Time to prescription of daily administrated asthma medication within two years following study enrollment (in days), Purchases of antibiotics and asthma medications during two years following study enrollment

Source: https://euclinicaltrials.eu/ctis-public/view/2024-512561-13-00